EU clinical trial 2024-518637-28-00: Effects of a single denosumab injection on reduction of total contact cast treatment and consolidation of bone fractures caused by acute Charcot foot in patients with diabetes mellitus (CHARCOT study)
Sponsor: Amsterdam UMC Stichting (Patient organisation/association). Phase: Therapeutic confirmatory (Phase III). Countries: Netherlands (ended).
Therapeutic area(s): Diseases [C] - Pathological Conditions, Signs and Symptoms [C23]; Diseases [C] - Musculoskeletal Diseases [C05]
Gender: Female, Male. Age: 18-64 years, 65+ years. Enrolment: 30.
Status: Ended. End date (EU): 2024-12-17. Decision date: 2024-11-01. Results received: Yes. Last updated: 2024-11-01.

Condition(s): Charcot, diabetes
Product: SALINE, DENOSUMAB

Primary endpoint: Time to cession of total contact cast (Days) in combination with curation of foot fractures (by independent radiologist) upon denosumab treatment at baseline, 3,6 and 9 months in diabetes patients with proven Charcot foot (blindly analysed by prof Maas, dept. of Radiology AMC)
Endpoint(s): Prevention of foot deformation (as determined by plantar pressure measurements before and in diabetes patients with radiologically proven Charcot foot. Also changes in volume (water displacement) and foot temperature of both feet as well as clinical risk score will be determined at these time points.

Source: https://euclinicaltrials.eu/ctis-public/view/2024-518637-28-00